EU clinical trial 2023-509075-17-00: RANDOMIZED, CONTROLLED, OPEN, MULTICENTRIC CLINICAL TRIAL TO EVALUATE THE EFFICACY AND SAFETY OF A COMBINATION OF ANTI-TUBERCULOUS DRUGS BASED ON HIGH DOSE RIFAMPICIN, HIGH DOSE MOXIFLOXACIN AND LINEZOLID IN PATIENTS WITH BACILLIFEROUS PULMONARY TUBERCULOSIS (RML-TB).
Protocol code: RML-TB
Sponsor: Fundacio Hospital Universitari Vall D’Hebron Institut De Recerca (Laboratory/Research/Testing facility). Phase: Therapeutic exploratory (Phase II). Countries: Spain (ended).
Therapeutic area(s): Diseases [C] - Bacterial Infections and Mycoses [C01]
Gender: Female, Male. Age: 18-64 years. Enrolment: 120.
Status: Ended. Start date (EU): 2024-01-17. End date (EU): 2025-04-10. Decision date: 2023-11-20. Results received: Yes. Last updated: 2025-06-27.

Condition(s): Bacilliferous pulmonary tuberculosis
Product: Rimactan 300 mg hörð hylki., Moxifloxacin Tillomed 400 mg film coated tablets, LINEZOLID, RIMSTAR®, COMPRIMIDOS RECUBIERTOS CON PELÍCULA, Hidroxil B1-B6-B12 comprimidos recubiertos con película, Zyvoxid 600 mg Filmtabletten

Primary endpoint: Efficacy: Proportion of patients with sterilization of sputum culture in liquid medium 8 weeks after starting treatment Safety: Proportion of patients with grade 3 or higher adverse events according to CTCAE V5.
Endpoint(s): To evaluate the tolerability of the experimental arm at 8 weeks after randomization. To evaluate the dynamics of efficacy of the experimental arm vs. control arm using the decrease in time until positive culture and time until sputum becomes negative.Analyze the correlation between the PK parameters To evaluate the quality of life of the patients. Carry out a cost-effectiveness study.To analyze the immunological and inflammatory pattern of the study participants

Source: https://euclinicaltrials.eu/ctis-public/view/2023-509075-17-00